EU clinical trial 2022-501092-11-00: Effect of psilocybin on the positive valence system in treatment-resistant depression: a pilot clinical neuroimaging study
Protocol code: NIMAO/2021-2/JLC-01
Sponsor: Centre Hospitalier Universitaire De Nimes (Hospital/Clinic/Other health care facility). Phase: Therapeutic exploratory (Phase II). Countries: France (ended).
Therapeutic area(s): Psychiatry and Psychology [F] - Mental Disorders [F03]
Gender: Female, Male. Age: 18-64 years. Enrolment: 20.
Status: Ended. Start date (EU): 2024-11-05. End date (EU): 2025-09-26. Decision date: 2024-09-26. Results received: No. Last updated: 2024-09-26.

Condition(s): depression, mental disorders
Product: PSILOCYBINE

Primary endpoint: Brain activity measured by fMRI in regions involved in effort assessment before and after treatment: basolateral amygdala, dorsal anterior cingulate cortex, ventral pallidum, ventral striatum, ventral tegmental area
Endpoint(s): Delta depression scores before & after treatment (Quick Inventory of Depressive Symptomatology, Clinician Rated and Self-report) at inclusion visit, 4 days, 1 month and 3 months., Delta of Behavioral Activation for Depression Scale (BADS) and Snaith-Hamilton Pleasure Scale (SHAPS) scores before and after treatment., Evaluation of therapy administration sessions by patients: satisfaction, number and severity of adverse events or tolerance problems reported., 5-Dimensional Altered States of Consciousness Questionnaire score.

Source: https://euclinicaltrials.eu/ctis-public/view/2022-501092-11-00